EU clinical trial 2024-517032-22-00: Long-term extension study to evaluate the safety and efficacy of riliprubart (SAR445088) in participants with chronic inflammatory demyelinating polyneuropathy (CIDP)
Protocol code: LTS17261
Sponsor: Sanofi-Aventis Recherche & Developpement (Pharmaceutical company). Phase: Therapeutic confirmatory (Phase III). Countries: Portugal (ongoing, recruiting), Poland (ongoing, recruiting), Belgium (authorised, recruitment pending), Hungary (authorised, recruitment pending), Czechia (ongoing, recruiting), Greece (authorised, recruitment pending), Netherlands (ongoing, recruiting), Denmark (ongoing, recruiting), Italy (ongoing, recruiting), Germany (ongoing, recruiting), Sweden (ongoing, recruiting), Spain (ongoing, recruiting), Bulgaria (ongoing, recruiting), France (ongoing, recruiting).
Therapeutic area(s): Diseases [C] - Immune System Diseases [C20]
Gender: Female, Male. Age: 18-64 years, 65+ years. Enrolment: 155.
Start date (EU): 2025-06-10. Decision date: 2025-04-22. Results received: No. Last updated: 2026-07-30.
Decision dates by country: BE: 2025-04-24, DK: 2025-04-23, CZ: 2025-04-23, SE: 2025-04-30, PL: 2025-04-27, HU: 2025-04-28, PT: 2025-04-24, ES: 2025-04-30, IT: 2025-04-30, GR: 2025-04-30, NL: 2025-04-22, FR: 2025-04-28, BG: 2025-04-28, DE: 2025-04-24

Condition(s): Immune system diseases.
Product: riliprubart

Primary endpoint: Number of participants having any adverse events (AEs), serious adverse events (SAEs), adverse events leading to treatment discontinuation, adverse events of special interest (AESIs), and potentially clinically significant abnormalities (PCSAs) in safety laboratory tests, electrocardiograms (ECGs), and vital signs during the study period.
Endpoint(s): Percentage of participants relapse-free since the first dose of riliprubart in the parent study (PDY16744, EFC17236, or EFC18156)., Percentage of participants experiencing improvement from baseline., Change from baseline in adjusted Inflammatory Neuropathy Cause and Treatment (INCAT) disability score over time., Change from baseline in Inflammatory Rasch-built Overall Disability Scale (I-RODS) over time., Change from baseline in grip strength (kilopascals; dominant hand) over time., Change from baseline in Medical Research Council-Sum Score (MRC-SS) for muscle strength over time.

Source: https://euclinicaltrials.eu/ctis-public/view/2024-517032-22-00